EU clinical trial 2025-521859-23-00: A phase Ib/II open-label, multi-center study of the DNA protein kinase inhibitor AMO959 with lutetium (177Lu) vipivotide tetraxetan (AAA617) in combination with an androgen receptor pathway inhibitor (ARPI) in adult participants with PSMA-positive metastatic castration resistant prostate cancer (mCRPC)
Protocol code: CAMO959A12103
Sponsor: Novartis Pharma AG (Pharmaceutical company). Phase: Phase I and Phase II (Integrated)- Other. Countries: Germany (ongoing, recruiting), France (ongoing, recruiting), Spain (ongoing, recruiting), Italy (ongoing, recruiting).
Therapeutic area(s): Diseases [C] - Neoplasms [C04]
Gender: Male. Age: 18-64 years, 65+ years. Enrolment: 73.
Status: Ongoing, recruiting. Start date (EU): 2026-03-31. Decision date: 2026-03-05. Results received: No. Last updated: 2026-08-05.
Decision dates by country: IT: 2026-03-10, FR: 2026-03-05, DE: 2026-03-05, ES: 2026-03-06

Condition(s): PSMA-positive mCRPC with prior exposure to at least one prior ARPI
Product: Prednison acis 5 mg, DEGARELIX, Pluvicto 1 000 MBq/mL solution for injection/infusion, AMO959, PIFLUFOLASTAT (18F), DEGARELIX, ENZALUTAMIDE, GOZETOTIDE, Prednison 5 mg GALEN® Tabletten, Abiraterone, AMO959, ABIRATERONE, Enzalutamide, RELUGOLIX

Primary endpoint: Incidence of dose limiting toxicities (DLTs) with AMO959 in combination with AAA617 +/- ARPI during the first cycle (42 days from first dose of AAA617) of combination treatment, Safety: Type, incidence and severity of AEs and SAEs, changes in laboratory values, and vital signs, and deaths, Tolerability: Incidence of dose interruptions, reductions, and discontinuation; dose intensity and duration of exposure, Biochemical response (PSA50), defined as the proportion of participants who achieved a ≥ 50% decrease in PSA from baseline at any time during the treatment period prior to start of new anti-cancer therapy that is confirmed by a second PSA measurement ≥ 4 weeks later.
Endpoint(s): PSA90 is defined as the proportion of participants who achieved a ≥ 90% decrease from baseline at any time during the treatment period prior to start of new anti-cancer therapy that is confirmed by a second PSA measurement ≥ 4 weeks. Only for Phase Ib: PSA50 defined as above Only for Phase II: PSA50 in the AAA617 + ARPI arm as defined above, rPFS: time from start of study treatment/randomization to radiographic PD/death ORR: proportion of participants with CR/PR DCR: proportion of participants with CR, PR, SD, Non-CR/Non-PD DoR: time from CR/PR to PD/death TTSTP: time from randomization to soft tissue PD OS: time from start of study treatment/randomization to death, Plasma concentrations of AMO959 over time and derived PK parameters., Concentrations of AAA617 in blood over time and PK parameters from blood radioactivity data, Time activity curves (TACs) and absorbed radiation doses in selected organs and tumor lesions., Safety: Type, incidence and severity of AEs and SAEs, changes in laboratory values, and vital signs, and deaths. Tolerability: Incidence of dose interruptions, reductions, and discontinuation; dose intensity and duration of exposure., rPFS-PET is defined as the time from the date of randomization to first documented radiographic disease progression (an increase in PSMA-positive tumor volume ≥ 20% from baseline and new PSMA-positive malignant lesions) as assessed by BICR using PSMA PET/CT imaging (Seifert et al 2023, Gafita et al 2023) or death due to any cause, whichever occurs first., Change from baseline in FACT-P Prostate Cancer Subscale (PCS) Time to worsening on the Worst Pain defined as the time from the date of randomization to the first occurrence of worsening on the Brief Pain Inventory – Short Form (BPI-SF) Worst Pain item of at least 30% increase from baseline or a minimum of 2 points increase from baseline or death due to any cause, whichever occurs first., TTSSE defined as date of randomization to the date of first new symptomatic pathological bone fracture, spinal cord compression, tumor-related orthopedic surgical intervention, requirement for radiation therapy to relieve bone pain or death from any cause, whichever occurs first.

Source: https://euclinicaltrials.eu/ctis-public/view/2025-521859-23-00